EU clinical trial 2025-524010-28-00: A Phase 1/2 Trial of RPTR-1-201, a T Cell Receptor Bispecific Therapy, in Advanced Solid Tumors
Protocol code: RPTR-1-201-101
Sponsor: Repertoire Immune Medicines Inc. (Pharmaceutical company). Phase: Phase I and Phase II (Integrated)- First administration to humans. Countries: Spain (ongoing, recruiting), Ireland (authorised, recruitment pending), Portugal (authorised, recruitment pending), France (authorised, recruitment pending).
Therapeutic area(s): Diseases [C] - Neoplasms [C04]
Gender: Female, Male. Age: 18-64 years, 65+ years. Enrolment: 87.
Start date (EU): 2026-03-20. Decision date: 2026-03-17. Results received: No. Last updated: 2026-07-27.
Decision dates by country: ES: 2026-03-17, IE: 2026-07-24, PT: 2026-07-14, FR: 2026-07-27

Condition(s): Advanced Solid Tumor
Product: KEYTRUDA 25 mg/mL concentrate for solution for infusion.

Primary endpoint: 1. Phase 1: Number of participants with dose-limiting toxicities and treatment-emergent adverse events., 2. Phase 2: Objective Response Rate (ORR) per RECIST v1.1
Endpoint(s): 1. All Phases: Incidence and severity of adverse events, including immune-related adverse events, and abnormal safety assessments (clinical laboratory tests, ECGs, vital signs), 2. Phase1: Characterization of the pharmacokinetic profile of RPTR-1-201 (for example, maximum observed concentration and exposure over time), initial pharmacodynamics, and incidence of anti-drug antibodies, 3. Phase1: ORR and best overall response (BOR: CR, PR, stable disease [SD], or progressive disease [PD]) by RECIST v1.1 and iRECIST, 4. Phase 1: Duration of response (DOR) by RECIST v1.1 and iRECIST, 5. Phase 1: Disease control rate (CR+PR+SD), 6. Phase 1 and 2: PFS and TTR by RECIST v1.1 and iRECIST, 7. Phase 2: Overall survival (OS)

Source: https://euclinicaltrials.eu/ctis-public/view/2025-524010-28-00